EU clinical trial 2024-519620-24-01: Avacopan added to standard-of-care therapy in ANCA-associated vasculitis with severe kidney involvement: a randomized, placebo-controlled, double-blinded multicenter superiority study
Protocol code: RC31/24/0321
Sponsor: Centre Hospitalier Universitaire De Toulouse (Hospital/Clinic/Other health care facility). Phase: Therapeutic confirmatory (Phase III). Countries: France (temporarily halted).
Therapeutic area(s): Diseases [C] - Immune System Diseases [C20]
Gender: Female, Male. Age: 18-64 years, 65+ years. Enrolment: 130.
Status: Temporarily halted. Start date (EU): 2026-06-01. Decision date: 2025-11-27. Results received: No. Last updated: 2026-07-08.

Condition(s): ANCA-associated vasculitis
Product: AMG 569, RITUXIMAB, METHYLPREDNISOLONE, PREDNISONE, PREDNISOLONE, placebo for amg 569, OBINUTUZUMAB, CYCLOPHOSPHAMIDE

Primary endpoint: Proportion of patients reaching an estimated glomerular filtration rate > or =30 mL/min/1.7m² (CKD-EPI formula applied to the measure of standardized serum creatinine) at week 52 without requiring treatment study discontinuation for serious adverse event or treatment modification or intensification for refractory vasculitis or relapse
Endpoint(s): Survival (at week 52 and 64; % and survival curves), Birmingham Vasculitis Activity Score (BVAS; evaluation at weeks 0, 20, 52, 64) and Vasculitis Damage Index (change between baseline (week 0) and weeks 20, 52 and 64, respectively), Proportion of patients achieving disease remission (defined as BVAS score = 0) at weeks 20, 52 and 64, Changes in eGFR from baseline (in mL/min/1.7m2; CKD-EPI formula derived from the serum creatinine) and weeks 20, 52 and 64, respectively, Urinary protein/creatinine ratio (mg/mmol) and urinary albumin/creatinine ratio (mg/mmol) at week 20, 52 and 64, Number and percentage of patients requiring chronic dialysis at weeks 20, 52 and 64, Urinary levels of MCP-1 and soluble CD163, Urinary and serum levels of C3a, C5a and factor Bb (evaluation at inclusion and at weeks 4, 12, 20, and 52), Short Form-36 v.2 component and domain scores and the EuroQOL-5D-5L visual analogue scale (in mm) and index: change between baseline and week 64, Brix / Berden scores, C3 deposits in glomeruli, interstitial fibrosis, glomerulosclerosis, percentage of extra-capillary crescents measured at baseline, Occurrence of infections, diabetes mellitus, hepatitis and other adverse events (inclusion to week 64)

Source: https://euclinicaltrials.eu/ctis-public/view/2024-519620-24-01